EU clinical trial 2024-519208-29-00: IFCT-2402 LAG-MAPS A non-comparative phase IIR trial assessing fianlimab plus cemiplimab plus pemetrexed-platinum chemotherapy or cemiplimab plus pemetrexed-platinum chemotherapy for treatment-naive Pleural Mesothelioma (PM) patients
Sponsor: Intergroupe Francophone De Cancerologie Thoracique (Patient organisation/association). Phase: Therapeutic exploratory (Phase II). Countries: France (ongoing, recruiting).
Therapeutic area(s): Diseases [C] - Neoplasms [C04]
Gender: Female, Male. Age: 18-64 years, 65+ years. Enrolment: 126.
Status: Ongoing, recruiting. Start date (EU): 2026-04-02. Decision date: 2025-11-06. Results received: No. Last updated: 2025-11-06.

Condition(s): Pleural mesothelioma
Product: Fianlimab, LIBTAYO 350 mg concentrate for solution for infusion.

Primary endpoint: Disease Control Rate (DCR) at 6 months, according to RECIST1.1 criteria modified for mesothelioma, as assessed by an Independent Review Committee (IRC)
Endpoint(s): Incidence, nature, and severity of adverse events (AE), graded according to the National Cancer Institute Common Terminology Criteria for Adverse Events, Version 5.0 (NCI CTCAE v5.0), Rate of Hyper-Progressive Disease (HPD), Progression Free Survival (PFS) as assessed by an IRC, PFS as assessed by the investigator, PFS according to the histological subtype epithelioid vs. non-epithelioid, Overall Survival (OS), Best Overall Response Rate (ORR), Clinically significant changes in symptoms and function, using EQ-5D-5L and LCSS-meso scores

Source: https://euclinicaltrials.eu/ctis-public/view/2024-519208-29-00